EU clinical trial 2024-517030-17-00: BOSICART - Bosentan in the treatment of Giant Cell Arteritis
Protocol code: APHP200041
Sponsor: Assistance Publique Hopitaux De Paris (Hospital/Clinic/Other health care facility). Phase: Therapeutic exploratory (Phase II). Countries: France (authorised, recruitment pending).
Therapeutic area(s): Diseases [C] - Cardiovascular Diseases [C14]
Gender: Female, Male. Age: 18-64 years, 65+ years. Enrolment: 40.
Status: Authorised, recruitment pending. Decision date: 2025-08-11. Results received: No. Last updated: 2026-03-25.

Condition(s): Newly diagnosed or relapsing Giant-cell arteritis
Product: PREDNISONE, PREDNISOLONE, BOSENTAN

Primary endpoint: Failure free survival at W52. A failure is defined by the occurrence of a relapse or the impossibility to decrease GC according to the predefined scheduled GC scheme.
Endpoint(s): 1) Proportion of new ischemic event at W 52, 2) Proportion of patients in remission without prednisone at W52, 3) Proportion of patients in remission with prednisone ≤5 mg/day at W52, 4) Cumulative dose of prednisone at W52, 5) Quality of life measured by HAQ and SF36 at W 26 and W52, 6) Proportion of patient in remission at year 2, Secondary objectives and endpoints • SECONDARY objectives • EFFICACY: 1) To compare the occurrence of new ischemic event 2) To compare (bosentan versus reference group) the proportion of patients in remission without prednisone at W52 3) To compare (bosentan versus reference group) the proportion of patients in remission with ≤5 mg/day of prednisone at W52 4) To assess the GC-sparing effect of bosentan in the treatment of GCA 5) To assess the effect of bosentan on quality of life 6) To compare, 8) Proportion of patients receiving GC at year 2, 1) Frequency and type of side effects within 1 year after inclusion

Source: https://euclinicaltrials.eu/ctis-public/view/2024-517030-17-00